EU clinical trial 2022-501607-27-00: Open-label dose-finding and dose-expansion study to evaluate the safety, expansion, persistence, and clinical activity of UCART20x22 in subjects with relapsed or refractory B-cell Non-Hodgkin Lymphoma (B-NHL)
Sponsor: Cellectis (Pharmaceutical company). Phase: Phase I and Phase II (Integrated)- First administration to humans. Countries: Spain (ongoing, recruiting), France (ongoing, recruiting), Italy (authorised, recruitment pending).
Therapeutic area(s): Diseases [C] - Neoplasms [C04]
Gender: Female, Male. Age: 18-64 years, 65+ years. Enrolment: 48.
Start date (EU): 2026-01-06. Decision date: 2023-03-08. Results received: No. Last updated: 2026-06-30.
Decision dates by country: IT: 2024-11-21, ES: 2023-03-21, FR: 2023-03-08

Condition(s): Relapsed or refractory B-cell Non-Hodgkin lymphoma
Product: UCART20X22, PROLEUKIN, 18x106 UI polvo para solución inyectable o para perfusión, PROLEUKIN 18 millions U.I., poudre pour solution injectable, ENDOXAN 1000 mg, poudre pour solution injectable, Proleukin 18 x 106 UI Polvere per soluzione iniettabile o per infusione, CLLS52, Proleukin® S 18 x 10 6 IE Pulver zur Herstellung einer Injektionslösung oder Infusionslösung, Genoxal 1.000 mg polvo para solución inyectable y para perfusión, LEMTRADA 12 mg concentrate for solution for infusion, Fludarabina Teva 25 mg/ml concentrado para solución para perfusión o inyección EFG, FLUDARA 50 mg, poudre pour solution injectable ou perfusion

Primary endpoint: For the dose-finding part: Incidence, nature and severity of AEs and SAEs Proportion of subjects in each dose-level cohort with DLT during the DLT Observation Period For the dose-expansion part: Incidence, nature, and severity of AEs and SAEs during the dose-expansion part Incidence, nature, and severity of AEs and SAEs associated with LD in dose-expansion part
Endpoint(s): : For the dose-finding and dose-expansion parts: Investigator assessed ORR according to Lugano response criteria. PFS, OS, and DoR Incidence, nature, and severity of AEs and SAEs associated with LD, associated antitumor activity, and corresponding host T-cell recovery and CAR T-cell expansion Quantitation of alemtuzumab levels in serum, evaluation of alemtuzumab PK parameters, TBNK panel and lymphocyte count

Source: https://euclinicaltrials.eu/ctis-public/view/2022-501607-27-00